EU clinical trial 2023-507743-11-00: A phase I/II, multicenter, randomized, double-blind, placebo within-patient controlled, first-in-human (FIH) Proof of Concept (PoC) study to evaluate the safety and efficacy of topically applied SXR1096 cream in patients with Netherton syndrome (NS)
Protocol code: SXR001
Sponsor: Sixera Pharma AB (Pharmaceutical company). Phase: Phase I and Phase II (Integrated)- First administration to humans. Countries: Germany (ended), France (ended), Austria (ended), Sweden (ended).
Therapeutic area(s): Diseases [C] - Skin and Connective Tissue Diseases [C17]
Gender: Female, Male. Age: 18-64 years. Enrolment: 24.
Status: Ended. Start date (EU): 2022-02-18. End date (EU): 2025-06-09. Decision date: 2023-10-23. Results received: Yes. Last updated: 2025-04-07.
Decision dates by country: AT: 2023-10-23, SE: 2024-01-17, DE: 2023-10-23, FR: 2023-10-23

Condition(s): Netherton syndrome (NS)

Primary endpoint: • Primary endpoints: • Safety assessment includes adverse events (nature and incidence), physical examination, vital signs, laboratory safety, and local tolerability. • Primary efficacy endpoint: o The change in Investigator Global Assessment (IGA) score 0-4 (see table in Appendix B) at EOT compared to baseline.
Endpoint(s): • Secondary efficacy endpoints: • The skin condition will be characterized primarily by Ichthyosis Area Severity Index (IASI), which integrates erythema (IASI-E) and scaling (IASI-S); this score has been recently developed and validated by applying it to patients affected with NS (Paller et al., 2017). • Skin itching will be assessed by VAS and a multidimensional 5-D pruritus scale (Phan et al., 2012). • Skin surface pH and transepidermal water loss (TEWL) will be measured on treated areas.

Source: https://euclinicaltrials.eu/ctis-public/view/2023-507743-11-00